EU clinical trial 2023-503245-58-00: A Phase 3, Randomized, Double-blind, Placebo-Controlled, Multicenter Study of ABSK021 to Assess the Efficacy and Safety in Patients with Tenosynovial Giant Cell Tumor
Protocol code: ABSK021-301
Sponsor: Abbisko Therapeutics Co. Ltd. (Laboratory/Research/Testing facility). Phase: Therapeutic confirmatory (Phase III). Countries: Italy (ongoing, recruitment ended), Spain (ongoing, recruitment ended), France (ended), Netherlands (ongoing, recruitment ended), Poland (ongoing, recruitment ended).
Therapeutic area(s): Diseases [C] - Neoplasms [C04]
Gender: Female, Male. Age: 18-64 years, 65+ years. Enrolment: 28.
Start date (EU): 2023-10-04. Decision date: 2023-09-04. Results received: No. Last updated: 2026-05-15.
Decision dates by country: FR: 2023-09-04, IT: 2023-09-04, PL: 2023-09-04, NL: 2023-09-04, ES: 2023-09-04

Condition(s): Tenosynovial Giant Cell Tumor
Product: Placebo, ABSK021

Primary endpoint: 25-Week Objective Response Rate (ORR) by Blinded Independent Review Committee (BIRC) based on RECIST 1.1.
Endpoint(s): 25-Week Objective Response Rate (ORR) by Blinded Independent Review Committee (BIRC) based on Tumor Volume Score (TVS), Mean change from baseline in Range of Motion (ROM) of the affected joint at Week 25., Mean change from baseline in the Worst Stiffness Numeric Rating Scale (NRS) score at Week 25, Mean change from baseline in the Worst Pain Numeric Rating Scale (NRS) score at Week 25, Mean change from baseline in the Patient-reported Outcomes Measurement Information System (PROMIS) Physical Functioning score at Week 25, Mean change from baseline in EuroQol visual analogue scale (VAS) score at Week 25, Duration of Response (DOR) by Blinded Independent Review Committee based on RECIST 1.1., Duration of Response (DOR) by Blinded Independent Review Committee based on Tumor Volume Score (TVS).

Source: https://euclinicaltrials.eu/ctis-public/view/2023-503245-58-00